EU clinical trial 2024-518721-15-00: In vivo involvement of the cholinergic and dopaminergic systems in the pathophysiology of apathy. ADACHOL.
Sponsor: Centre Hospitalier Universitaire De Bordeaux (Hospital/Clinic/Other health care facility). Phase: Therapeutic confirmatory (Phase III). Countries: France (ongoing, recruiting).
Therapeutic area(s): Analytical, Diagnostic and Therapeutic Techniques and Equipment [E] - Diagnosis [E01]
Gender: Female, Male. Age: 18-64 years, 65+ years. Enrolment: 30.
Status: Ongoing, recruiting. Start date (EU): 2021-04-13. Decision date: 2024-11-14. Results received: No. Last updated: 2024-11-14.

Condition(s): Apathy
Product: Fluoroethoxybenzovesamicol F-18, Dopacis 90 MBq/mL, solution injectable

Primary endpoint: [18F]-FEOBV and [18F]-FDOPA binding intensities
Endpoint(s): Clinical severity of apathy, Functional connectivity parameters measured with MRI, Diffusion tensor imaging parameters, such as the fractional anisotropy and mean diffusivity, measured with structural MRI, Cerebral blood flow

Source: https://euclinicaltrials.eu/ctis-public/view/2024-518721-15-00